EU clinical trial 2023-510198-32-00: Zoledronate Early to Hip Fractures Patients – safe and effective? A Randomized controlled double-blinded treatment strategy trial on Zoledronate in hip fracture patients: The ZEBRA trial
Sponsor: Oslo University Hospital HF (Hospital/Clinic/Other health care facility). Phase: Therapeutic use (Phase IV). Countries: Norway (ended).
Therapeutic area(s): Diseases [C] - Musculoskeletal Diseases [C05]
Gender: Female, Male. Age: 18-64 years, 65+ years. Enrolment: 300.
Status: Ended. Start date (EU): 2021-12-01. End date (EU): 2026-06-11. Decision date: 2024-06-19. Results received: No. Last updated: 2024-06-19.

Condition(s): Hip fracture
Product: ZOLEDRONIC ACID, ELECTROLYTES

Primary endpoint: Difference between the two groups in proportion of patients having P1NP>35µg/L 12 months after treatment with zoledronate
Endpoint(s): Grade of early mobilization measured by CAS score in hospital/at discharge from hospital, Number of patients with delirium assessed by 4AT in hospital, Difference between the two groups in proportion of patients having CTX>0.28µg/L 12 months after treatment with zoledronate, Change in BMD 12 months after treatment with zoledronate, Grade of mobilization and rehabilitation 3 months after fracture measured by TUG test, Number of patients with fever (T> 38’C) in hospital, Number of patients treated with antibiotics in hospital, Time to discharge from hospital after admission and after the hip fracture surgery, Time to and number of readmissions to hospital (any department), Time to and number of new fractures, Time to and number of deaths

Source: https://euclinicaltrials.eu/ctis-public/view/2023-510198-32-00